EU clinical trial 2022-501944-14-00: The Pancreatic Enzymes after Gastrectomy Trial
Protocol code: PANEM
Sponsor: University of Leipzig (Educational Institution). Phase: Therapeutic confirmatory (Phase III). Countries: Germany (ongoing, recruiting).
Therapeutic area(s): Diseases [C] - Digestive System Diseases [C06]
Gender: Female, Male. Age: 18-64 years, 65+ years. Enrolment: 188.
Status: Ongoing, recruiting. Start date (EU): 2023-10-02. Decision date: 2023-04-24. Results received: No. Last updated: 2026-04-15.

Condition(s): Patients after gastrectomy (total and partial)
Product: Nortase®, Placebo to Test

Primary endpoint: Disease specific quality of life (QOL) at 6 months according to the physical sub-score of the EORTC-QLQ-C30

Source: https://euclinicaltrials.eu/ctis-public/view/2022-501944-14-00